EU clinical trial 2023-510140-21-00: Intraoperative Sufentanil and chronic postsurgical pain in non-major scheduled abdominal surgery
Protocol code: PI2023_843_0173
Sponsor: Centre Hospitalier Universitaire Amiens Picardie (Hospital/Clinic/Other health care facility). Phase: Therapeutic use (Phase IV). Countries: France (ongoing, recruiting).
Therapeutic area(s): Diseases [C] - Digestive System Diseases [C06]
Gender: Female, Male. Age: 18-64 years, 65+ years. Enrolment: 855.
Status: Ongoing, recruiting. Start date (EU): 2024-06-24. Decision date: 2024-03-22. Results received: No. Last updated: 2024-03-22.

Condition(s): Chronic postsurgical pain in non-major scheduled abdominal surgery
Product: SUFENTANIL

Primary endpoint: Incidence of CPSP at 3 months after non-major scheduled abdominal surgery
Endpoint(s): Post-operative pain intensity assessed by NRS of 11 points at 24 hours and 48 hours after operating room discharge, Time taken until the use of 3rd step analgesics, Consumption of opioid derivatives and opioids at 24 hours, 48 hours and 3 months after surgery, CPSP intensity at 3 months and neuropathic pain incidence at 3 months.

Source: https://euclinicaltrials.eu/ctis-public/view/2023-510140-21-00